EU clinical trial 2024-516427-13-00: Targeted glucocorticoid administration to improve safety learning in posttraumatic stress disorder patients with HPA axis dysregulation
Sponsor: Stichting Radboud universitair medisch centrum (Hospital/Clinic/Other health care facility). Phase: Therapeutic use (Phase IV). Countries: Netherlands (ongoing, recruiting).
Therapeutic area(s): Psychiatry and Psychology [F] - Mental Disorders [F03]
Gender: Female, Male. Age: 18-64 years. Enrolment: 190.
Status: Ongoing, recruiting. Start date (EU): 2024-10-28. Decision date: 2024-10-28. Results received: No. Last updated: 2026-05-21.

Condition(s): Posttraumatic Stress Disorder (PTSD)
Product: Placebo: PL1, Pharmaceutical form: Capsule, Route of administration: Oral use, Hydrocortison DMB 20 mg, tabletten

Primary endpoint: For substudy A, the main study parameters are (1) early life adversity, (2) Hypothalamic-pituitary-adrenal axis functioning, and (3) epigenetic mechanisms. For substudy B, the main study parameter regards retention of the safety memory within the VR contextual fear conditioning environment.
Endpoint(s): For substudy A, this includes (1) salivary cortisol response curve to the SECPT ( a validated stress test) and (2) treatment response to focused treatment for PTSD. For substudy B, this includes the following MRI endpoints (1) BOLD-fMRI response during fear extinction, (2) BOLD-fMRI general amygdala responsiveness during viewing of emotional faces (3) Resting state fMRI functional coupling between vmPFC and amygdala(4) Structural MRI (T1-weighted MP-RAGE) and DTI scans.

Source: https://euclinicaltrials.eu/ctis-public/view/2024-516427-13-00